EU clinical trial 2024-511966-36-00: The bilateral sentinel node detection rate of fluorescent indocyanine green compared to 99mTc and blue dye in the sentinel node procedure in stage I-IIA cervical cancer
Sponsor: Universitair Medisch Centrum Utrecht (Hospital/Clinic/Other health care facility). Phase: Phase III and phase IV (Integrated). Countries: Netherlands (ended).
Therapeutic area(s): Diseases [C] - Neoplasms [C04]
Gender: Female. Age: 18-64 years, 65+ years. Enrolment: 101.
Status: Ended. Start date (EU): 2021-04-26. End date (EU): 2025-08-07. Decision date: 2024-05-10. Results received: Yes. Last updated: 2024-05-10.

Condition(s): cervical cancer stage I-IIA
Product: INDOCYANINE GREEN

Primary endpoint: Bilateral detection rate of SLNs with ICG and NIR fluorescence imaging versus 99mTc with blue dye. A SLN is defined as the first lymph node(s) of each hemipelvis to receive afferent lymphatic drainage from the primary cervical tumour, identified by either ICG, gamma radiation using 99mTc or blue dye. Bilateral detection rate of a tracer/modality is defined as number of patients detected with at least one SLN in each hemipelvis divided by the total number of patients undergoing SLN procedure.
Endpoint(s): Overall detection rate (defined as the proportion of patients in which at least one SLN is detected) - Sensitivity and FNR (defined as the proportion of patients with tumour-negative SLNs and tumour-positive non-SLNs divided by the total number of patients with lymph node metastasis) of ICG and 99mTc and blue dye, with PLND as gold standard to confirm tumour positive non-SLNs (part of current standard-of-care)., The number of SLNs identified with NIR fluorescence, radioactivity and blue staining. - Concordance between ICG and 99mTc with blue dye in terms of SLN localisation, by strictly reporting all localisations and whether positive with ICG, SPECT-CT (preoperatively), 99mTc,or blue dye, or a combination of these. - Adverse events of ICG, 99mTc and/or blue dye; - The time to complete SLN detection with ICG versus 99mTc + blue dye, Cost-effectiveness, defined as the costs of the procedure versus the yielded bilateral detection rate of the procedure; - Patient satisfaction with the oncological care and procedure measured with the validated EORTC IN-PATSAT32 questionnaire; - Surgical evaluation of fluorescent imaging (usability) measured with two short questionnaires tailored for the surgeons.

Source: https://euclinicaltrials.eu/ctis-public/view/2024-511966-36-00